EU clinical trial 2024-518657-42-00: Augmenting ischemia-induced vasculo- and angiogenesis after endovascular reperfusion with host-extracted, percutaneously introduced, leucocyte- and platelet-rich fibrin in patients with critical limb ischemia
Protocol code: ARISTOTLE
Sponsor: Medical University Of Warsaw (Educational Institution). Phase: Human Pharmacology (Phase I)- First administration to humans. Countries: Poland (authorised, recruiting).
Therapeutic area(s): Diseases [C] - Cardiovascular Diseases [C14]
Gender: Female, Male. Age: 18-64 years, 65+ years. Enrolment: 100.
Status: Authorised, recruiting. Start date (EU): 2024-12-17. Decision date: 2025-01-28. Results received: No. Last updated: 2026-02-09.

Condition(s): critical limb ischemia
Product: Leukocyte-Platelet Rich Fibrin

Primary endpoint: the type and frequency of adverse reactions and events assessed during the study and at the final visit.
Endpoint(s): Secondary endpoints: mortality rate at the final visit, amputation rate at the final visit, time to revascularization (continuous assessment), amputation-free survival time (continuous assessment), muscle perfusion in imaging studies (at the final visit compared to baseline), ankle-brachial index (at the final visit compared to baseline), change in ischemia scores (Rutherford, WiFI) (at the final visit compared to baseline), and quality of life score at the final visit.

Source: https://euclinicaltrials.eu/ctis-public/view/2024-518657-42-00